EU clinical trial 2023-509566-38-00: Beamion BCGC-1: A Phase Ib dose escalation and Phase II dose optimization, randomized, open-label, multicenter trial of oral zongertinib (BI 1810631) alone or in combination with other agents for the treatment of patients with advanced HER2+metastatic breast cancer (mBC), metastatic gastric, gastroesophageal junction, or esophageal adenocarcinoma (mGEAC), or metastatic colorectal cancer (mCRC)
Protocol code: 1479-0012
Sponsor: Boehringer Ingelheim International GmbH (Pharmaceutical company). Phase: Phase I and Phase II (Integrated)- Other. Countries: Italy (ongoing, recruiting), Belgium (ongoing, recruiting), Spain (ongoing, recruiting), France (ongoing, recruiting), Germany (authorised, recruiting).
Therapeutic area(s): Diseases [C] - Neoplasms [C04]
Gender: Female, Male. Age: 18-64 years, 65+ years. Enrolment: 181.
Start date (EU): 2024-08-05. Decision date: 2024-06-10. Results received: No. Last updated: 2026-05-25.
Decision dates by country: FR: 2026-01-13, IT: 2024-06-12, ES: 2024-06-10, BE: 2024-06-11, DE: 2026-01-07

Condition(s): gastroesophageal junction adenocarcinoma, metastatic gastric adenocarcinoma, metastatic breast cancer, metastatic colorectal cancer, esophageal adenocarcinoma
Product: Herceptin 150 mg powder for concentrate for solution for infusion, Enhertu 100 mg powder for concentrate for solution for infusion, Fluorouracil Injection, 50 mg/ml, solution for injection, Ziihera 300 mg powder for concentrate for solution for infusion., Kadcyla 160 mg powder for concentrate for solution for infusion., Calciumfolinat Kabi 10 mg/ml Injektions-/Infusionslösung, Oxaliplatin Hikma 5 mg/ml Konzentrat zur Herstellung einer Infusionslösung, Xeloda 500 mg film-coated tablets, Xeloda 150 mg film-coated tablets, BI 1810631

Primary endpoint: Dose escalation (Phase Ib) Occurrence of DLTs in the MTD evaluation period. The MTD evaluation period is defined as the first 21 days of the first treatment cycle for Cohorts A, B, C, G, K, and O. The MTD evaluation period is defined as the first 28 days after the first administration of any trial medication for Cohorts M and N., Dose optimization and justification (Phase II) Objective response (OR) defined as the best overall response of confirmed complete response (CR) or confirmed partial response (PR) according to RECIST 1.1 from the date of treatment start until the earliest date of disease progression, death, or last evaluable tumor assessment before start of subsequent anti-cancer therapy, or treatment discontinuation as assessed by investigator review
Endpoint(s): Dose escalation (Phase Ib) OR, as described above, Occurrence of DLTs during the entire treatment period, Intensive PK sampling (for cycle 2 only): The following PK parameters of zongertinib when given in combination will be evaluated if feasible: o Cmax (SS): maximum measured concentration (at steady state) o AUC0-4h,ss : area under the concentration-time curve over the time interval from 0 to 4h at steady state o AUC0tz,ss: area under the concentration-time curve over the time interval from 0 to the last quantifiable data point at steady state, Dose optimization and justification (Phase II) o Progression-free survival (PFS), defined as the time from treatment start until the earliest date of tumor progression according RECIST 1.1 based on investigator review or death from any cause, whichever occurs first, Disease control (DC) defined as best overall response of CR or PR or stable disease (SD) where best overall response is defined according to RECIST 1.1 from first treatment administration until the earliest of disease progression, death, or last evaluable tumor assessment before start of subsequent anti-cancer therapy, or treatment discontinuation, as assessed by investigator review, Occurrence of treatment-emergent AEs (TEAEs) "redacted for CCI", Sparse PK sampling: The following PK parameters of zongertinib 1 when given as monotherapy or in combination will be evaluated if feasible: o Cmax (ss): maximum measured concentration (at steady state) o AUC0 tz, ss: area under the concentration-time curve over the time interval from 0 to the last quantifiable data point at steady state, PROs: PRO-CTCAE (Mouth/throat sores, Taste changes, Decreased appetite, Nausea, Vomiting, Constipation, Diarrhoea, Shortness of breath, Cough, Rash, Skin dryness, Hair loss, Itching, Numbness & Tingling, Fatigue, Nosebleed, Headache); EORTC IL46 (1 item, overall side effect impact); EORTC IL19 (5 items, physical functioning scale of EORTC QLQ-C30). The time frame is from first administration until an individual patient’s end of treatment (EOT).

Source: https://euclinicaltrials.eu/ctis-public/view/2023-509566-38-00